EU clinical trial 2024-513277-52-00: A Phase 3, Interventional, Randomized, Multicenter, Open-Label Study of DCC-2618 vs Sunitinib in Patients with Advanced Gastrointestinal Stromal Tumors after Treatment with Imatinib
Protocol code: DCC-2618-03-002
Sponsor: Deciphera Pharmaceuticals Inc. (Pharmaceutical company). Phase: Therapeutic confirmatory (Phase III). Countries: Spain (ongoing, recruitment ended), Netherlands (ongoing, recruitment ended), Norway (ongoing, recruitment ended), Italy (ongoing, recruitment ended), France (ended).
Therapeutic area(s): Diseases [C] - Neoplasms [C04]
Gender: Female, Male. Age: 18-64 years, 65+ years. Enrolment: 144.
Start date (EU): 2019-05-20. Decision date: 2024-09-04. Results received: No. Last updated: 2025-12-01.
Decision dates by country: FR: 2024-10-21, IT: 2024-09-23, ES: 2024-09-04, NL: 2024-09-08, NO: 2024-09-05

Condition(s): Patients with Advanced Gastrointestinal Stromal Tumors
Product: Sunitinib AqVida 12,5 mg Hartkapseln, QINLOCK 50 mg tablets

Primary endpoint: PFS of DCC-2618 based on independent radiologic review using mRECIST criteria.
Endpoint(s): Efficacy • ORR (confirmed CR + confirmed PR) based on independent radiologic review using mRECIST criteria • OS The primary and secondary endpoints will be analyzed for both the KIT Exon 11 (Exon 11 ITT) and the All Patients (AP ITT) population., Safety Safety endpoints that will be evaluated include treatment-emergent adverse events (TEAEs), SAEs, dose reduction or discontinuation of study drug due to toxicity; and changes from baseline in ECOG PS, vital signs, ECGs, LVEF, dermatologic examinations, and clinical laboratory parameters., Pharmacokinetics • Correlation of PK exposure with efficacy/safety • Population-based PK parameters

Source: https://euclinicaltrials.eu/ctis-public/view/2024-513277-52-00